EU clinical trial 2024-512113-41-00: A Multicentre, Randomised, Open-Label, Parallel-Group, Phase IIIb Study to Assess the Potential for Tezepelumab-treated Patients with Severe Asthma to Reduce Background Therapy While Sustaining Asthma Control and Clinical Remission (ARRIVAL)
Protocol code: D5180C00047
Sponsor: AstraZeneca AB (Pharmaceutical company). Phase: Therapeutic confirmatory (Phase III). Countries: Germany (ongoing, recruitment ended), Bulgaria (ongoing, recruitment ended), Denmark (ongoing, recruitment ended), Spain (ongoing, recruitment ended), France (ongoing, recruitment ended), Belgium (ongoing, recruitment ended), Italy (ongoing, recruitment ended).
Therapeutic area(s): Diseases [C] - Respiratory Tract Diseases [C08]
Gender: Female, Male. Age: 0-17 years, 18-64 years, 65+ years. Enrolment: 152.
Status: Ongoing, recruitment ended. Start date (EU): 2024-11-20. Decision date: 2024-10-28. Results received: No. Last updated: 2026-03-26.
Decision dates by country: IT: 2024-10-29, FR: 2024-10-28, DE: 2024-11-01, BE: 2024-10-30, BG: 2024-11-04, DK: 2024-10-28, ES: 2024-10-30

Condition(s): Severe Asthma
Product: Tezspire 210 mg solution for injection in pre-filled syringe

Primary endpoint: Proportion of patients who reduced their SYMBICORT® daily maintenance dose without the loss of asthma control at the end of the step-down phase (Week 56) to either: Outside of the US: • Medium-dose maintenance and reliever therapy, or • Low-dose maintenance and reliever therapy, or • SYMBICORT® anti-inflammatory reliever only

Source: https://euclinicaltrials.eu/ctis-public/view/2024-512113-41-00